EU clinical trial 2024-512275-12-00: The GOBLET trial: A clinical trial on GOblet cell density after Benzalkonium chloride and preservative-free Latanoprost Eye drop Treatment
Protocol code: WP3
Sponsor: Rigshospitalet (Hospital/Clinic/Other health care facility). Phase: Therapeutic use (Phase IV). Countries: Denmark (ended).
Therapeutic area(s): Diseases [C] - Eye Diseases [C11]
Gender: Female, Male. Age: 18-64 years, 65+ years. Enrolment: 28.
Status: Ended. Start date (EU): 2024-03-19. End date (EU): 2025-08-04. Decision date: 2024-03-19. Results received: No. Last updated: 2024-10-29.

Condition(s): Ocular hypertension, Primary open angle glaucoma
Product: Monoprost, øjendråber, opløsning, Xalatan, øjendråber, opløsning

Primary endpoint: change in Goblet cell density
Endpoint(s): Change in intraocular pressure, change in oxford score of fluorescein and lissamine staining of cornea and conjunctiva, change in conentration of mucin and cytokine concentration in tear film, Change in OSDI score

Source: https://euclinicaltrials.eu/ctis-public/view/2024-512275-12-00